EU clinical trial 2022-500389-84-00: SAFE study: Stopping Antibiotics after 3 days for the treatment of FEbrile Neutropenia in Haematology patients, a randomized open-label non-inferiority trial
Sponsor: UZ Leuven (Hospital/Clinic/Other health care facility). Phase: Therapeutic use (Phase IV). Countries: Belgium (ended).
Therapeutic area(s): Diseases [C] - Bacterial Infections and Mycoses [C01]
Gender: Female, Male. Age: 18-64 years, 65+ years. Enrolment: 410.
Status: Ended. Start date (EU): 2024-02-16. End date (EU): 2026-05-14. Decision date: 2023-08-23. Results received: No. Last updated: 2025-11-13.

Condition(s): Febrile neutropenia
Product: IMIPENEM, MEROPENEM, CEFEPIME, CEFTAZIDIME, PIPERACILLIN

Primary endpoint: Absence of a serious medical complication (SMC) following 42 days after randomisation. SMC is defined as: Death; and/or ICU admission; and/or Septic shock requiring vasopressive therapy.
Endpoint(s): Incidence of bacteraemia within 42 days after randomisation, Clinically documented infections, Number of documented bacterial infections, Total days of non-prophylactic antibiotics given to the patient at engraftment, Total numbers of antibiotic switches before neutrophil recovery, Incidence of Clostridium difficile infection, Incidence, severity and duration of diarrhea, Incidence of candidemia, Length of hospital stay in the first 42 days after randomization, Number of patients admitted to the ICU within 42 days after randomisation, Number of readmissions within 42 days, Number of patients with a culture (surveillance or diagnostic culture) positive for resistant bacteria: VRE; ESBL; MRSA; and/or CPE, Duration of hospitalization, Number of patients in the short treatment arm with ongoing fever at time of EBAT stop, Incidence of acute GVHD (grade II or higher) in the transplanted study population

Source: https://euclinicaltrials.eu/ctis-public/view/2022-500389-84-00